EU clinical trial 2023-507697-40-00: A Phase 3 Open-Label, Randomized Study of LOXO-305 versus Investigator’s Choice of Idelalisib plus Rituximab or Bendamustine plus Rituximab in BTK Inhibitor Pretreated Chronic Lymphocytic Leukemia/Small Lymphocytic Lymphoma (BRUIN-CLL-321)
Protocol code: LOXO-BTK-20020
Sponsor: Loxo Oncology Inc. (Pharmaceutical company). Phase: Therapeutic confirmatory (Phase III). Countries: Czechia (ongoing, recruitment ended), Hungary (ongoing, recruitment ended), Belgium (ongoing, recruitment ended), Germany (ongoing, recruitment ended), Austria (ongoing, recruitment ended), Ireland (ongoing, recruitment ended), Croatia (ongoing, recruitment ended), Poland (ongoing, recruitment ended), Italy (ongoing, recruitment ended), France (ongoing, recruitment ended), Spain (ongoing, recruitment ended).
Therapeutic area(s): Diseases [C] - Neoplasms [C04]
Gender: Female, Male. Age: 18-64 years, 65+ years. Enrolment: 128.
Status: Ongoing, recruitment ended. Start date (EU): 2021-07-05. Decision date: 2024-07-04. Results received: No. Last updated: 2026-07-21.
Decision dates by country: BE: 2024-07-04, HU: 2024-07-04, HR: 2024-07-05, DE: 2024-07-05, ES: 2024-07-08, AT: 2024-07-08, PL: 2024-07-05, FR: 2024-07-04, CZ: 2024-07-04, IE: 2024-07-04, IT: 2024-07-08

Condition(s): Chronic Lymphocytic Leukemia/Small Lymphocytic Lymphoma
Product: IDELALISIB, PIRTOBRUTINIB, PIRTOBRUTINIB, IDELALISIB, BENDAMUSTINE HYDROCHLORIDE, RITUXIMAB

Primary endpoint: Assessed by Independent Review Committee (IRC): • PFS per iwCLL 2018

Source: https://euclinicaltrials.eu/ctis-public/view/2023-507697-40-00